EU clinical trial 2024-511214-20-00: The MEMORINEPH study: Memory B cell level-based tailored treatment with Rixathon in children with complicated forms of steroid-sensitive Nephrotic syndrome
Protocol code: MEM_01_OPBG_2024
Sponsor: Ospedale Pediatrico Bambino Gesu' (Hospital/Clinic/Other health care facility). Phase: Therapeutic exploratory (Phase II). Countries: Italy (not authorised).
Therapeutic area(s): Diseases [C] - Female Urogenital Diseases and Pregnancy Complications [C13]; Diseases [C] - Male Urogenital Diseases [C12]
Gender: Female, Male. Age: 0-17 years, 18-64 years. Enrolment: 80.
Status: Not authorised. Decision date: 2024-10-25. Results received: No. Last updated: 2024-10-25.

Condition(s): Complicated forms of idiopathic steroid-sensitive nephrotic syndrome (SSNS)
Product: Rixathon 500 mg concentrate for solution for infusion, Rixathon 100 mg concentrate for solution for infusion, Rixathon 100 mg concentrate for solution for infusion, Rixathon 500 mg concentrate for solution for infusion

Primary endpoint: Evaluation of the number of RTX re-infusions comparing the two therapeutic regimens based on flow cytometry assessment of total B cell reconstitution (Arm A) or memory (Arm B) during a 24-month follow-up
Endpoint(s): Assessment during a 24-month follow-up of: • The number of relapses (defined as the reappearance of massive proteinuria (>40 mg/m²/h in children or urine protein/creatinine ratio > 2 g/g) or a positive urine dipstick (≥3+ for 3 days or positive for 7 days), with or without edema); • The number of hospitalization days; • The number of severe infections (defined as infections requiring hospitalization); • The time to the first relapse or a positive urine dipstick, Exploratory endpoints: Evaluation using immunoturbidimetry and ELISA tests of serum levels of total immunoglobulins IgG, IgM, and IgA, as well as antibody titers specific to tetanus and HBV induced by vaccination. • Assessment of the incidence of prolonged hypogammaglobulinemia (defined as IgG levels < age-specific normal range) and/or severe hypogammaglobulinemia (IgG < 250 mg/dl), with potential need for the introduction of replacement therapy with IgG.

Source: https://euclinicaltrials.eu/ctis-public/view/2024-511214-20-00